EU clinical trial 2024-518467-35-00: A trial to learn about how multiple doses of itraconazole change how AZD5004 moves throughout the body over time in healthy adults and how multiple doses of AZD5004 change how ethinyl estradiol and levonorgestrel move throughout the body overtime in healthy female adults
Protocol code: D7260C00007
Sponsor: AstraZeneca AB (Pharmaceutical company). Phase: Human Pharmacology (Phase I)- Other. Countries: Germany (ended).
Therapeutic area(s): Not possible to specify
Gender: Female, Male. Age: 18-64 years, 65+ years. Enrolment: 32.
Status: Ended. Start date (EU): 2025-05-28. End date (EU): 2026-01-28. End date: 2026-01-29. Decision date: 2025-04-25. Results received: No. Last updated: 2026-01-19.

Condition(s): Not applicable, healthy volunteers

Source: https://euclinicaltrials.eu/ctis-public/view/2024-518467-35-00